EU clinical trial 2023-503360-16-00: A Single-Ascending-Dose Study to Evaluate the Safety, Tolerability, and Pharmacokinetics of MK-4318 in Healthy Participants
Protocol code: MK-4318-001
Sponsor: Merck Sharp & Dohme LLC (Pharmaceutical company). Phase: Human Pharmacology (Phase I)- First administration to humans. Countries: Belgium (ended).
Therapeutic area(s): Diseases [C] - Nervous System Diseases [C10]
Gender: Female, Male. Age: 18-64 years. Enrolment: 32.
Status: Ended. Start date (EU): 2023-05-02. End date (EU): 2024-01-03. End date: 2024-01-04. Decision date: 2023-04-26. Results received: Yes. Last updated: 2023-12-07.

Condition(s): Acute and chronic pain
Product: Microcrystalline cellulose, Lactose Monohydrate, Magnesium Stearate (non-bovine), Microcrystalline cellulose, Lactose Monohydrate, Magnesium Stearate (non-bovine)

Primary endpoint: Number of participants who experienced adverse events (AEs), Number of participants who discontinued study intervention due to AEs, Area under the plasma concentration-time curve from 0 to infinity (AUC0-inf)) of MK-4318, Area under the plasma concentration-time curve from 0 to 24 hours (AUC0-24) of MK-4318, Time to maximum plasma concentration (Tmax) of MK-4318, Maximum plasma concentration (Cmax) of MK-4318, Plasma Concentration at 24 hours (C24) of MK-4318, Apparent oral clearance (CL/F) of MK-4318, Apparent Volume of Distribution During Terminal Phase (Vz/F) of MK-4318, Apparent terminal half-life (t½) of plasma concentration of MK-4318, Plasma Concentration at 12 hours (C12) of MK-4318
Endpoint(s): AUC-inf of MK-4318 with food effect, Cmax of MK-4318 with food effect, C24 of MK-4318 with food effect, C12 of MK-4318 with food effect

Source: https://euclinicaltrials.eu/ctis-public/view/2023-503360-16-00